EU clinical trial 2024-515480-66-01: Alkaline Phosphatase as treatment of Ischemia Reperfusion Injury to prevent delayed graft function
Sponsor: Stichting Amsterdam UMC (Hospital/Clinic/Other health care facility). Phase: Therapeutic exploratory (Phase II). Countries: Netherlands (ongoing, recruiting).
Therapeutic area(s): Diseases [C] - Immune System Diseases [C20]
Gender: Female, Male. Age: 18-64 years, 65+ years. Enrolment: 1.
Status: Ongoing, recruiting. Start date (EU): 2023-05-22. Decision date: 2024-11-04. Results received: No. Last updated: 2025-10-07.

Condition(s): End stage kidney disease - Kidney transplantation donors receiving kidneys from donation after circulatory death (DCD).
Product: bRESCAP, 0.9% sodium chloride (nacl, saline) is given as placebo. sodium chloride (0.9% nacl) is provided by the trial pharmacy of amsterdamUmc and is from baxter b.v. We have attached the most recent smPC from Baxter N.V. regarding the sodiumchloride 0.9%.

Primary endpoint: Difference between treatment and placebo group in delayed graft function (DGF) duration (in days) as measured on day 28. DGF is defined as need for dialysis within 7 days after transplantation, excluding single sessions for hyperkalemia. No need for dialysis will be registered as 0 days.
Endpoint(s): Mean duration of hospitalization after kidney transplantation, Incidence of persistent dialysis DGF (> 14 days), Incidence of functional and dialysis DGF, Duration of DGF using functional and dialysis definition and a combination of the two, Dall of serum creatinine in the first week after transplantation, Kidney perfusion contrast renography at day 6, Creatinine clearance at 3 months and 1 year after transplantation, Proteinuria at 3 months and 1 year after transplantation, Estimated renal glomerular filtration rate (eGFR) calculated with MDRD and the CKD-epi formula at 3 months and 1 year after transplantation, Primary non-function (defined as dialysis dependency or creatinine clearance <20ml/min at 3 months)., Incidence of biopsy proven rejection within one year follow-up period., All-cause mortality at day 28 and 90 and 1 year.

Source: https://euclinicaltrials.eu/ctis-public/view/2024-515480-66-01